EU clinical trial 2024-518545-13-00: A phase II, open label, randomised trial of ipilimumab and nivolumab with concurrent intracranial stereotactic radiotherapy versus ipilimumab and nivolumab alone in patients with melanoma brain metastases
Protocol code: MIA2019/CT/258
Sponsor: Melanoma Institute Australia (Hospital/Clinic/Other health care facility). Phase: Therapeutic exploratory (Phase II). Countries: Italy (authorised, recruitment pending).
Therapeutic area(s): Diseases [C] - Neoplasms [C04]
Gender: Female, Male. Age: 18-64 years, 65+ years. Enrolment: 20.
Status: Authorised, recruitment pending. Decision date: 2024-12-09. Results received: No. Last updated: 2026-07-31.

Condition(s): melanoma brain metastases
Product: OPDIVO 10 mg/mL concentrate for solution for infusion., YERVOY 5 mg/ml concentrate for solution for infusion

Primary endpoint: The incidence of neurological-specific death in the whole patient population at 1 year, from start of nivolumab and ipilimumab, where the immediate cause of death is due to brain metastases
Endpoint(s): The best response in intracranial metastases as measured using brain modified (bm) RECIST, following at least ONE dose of nivolumab and ipilimumab and based on imaging from week 12 onwards and confirmed a minimum of 4 weeks later, The best response in extracranial disease for each patient measured using bm RECIST, following at least ONE dose of nivolumab and ipilimumab and based on imaging from week 12 onwards and confirmed a minimum of 4 weeks later, Proportion of patients with an overall complete or partial response as measured using bm RECIST following at least ONE dose of nivolumab and ipilimumab and based on imaging from week 12 onwards and confirmed a minimum of 4 weeks later, a. Time from the start of nivolumab and ipilimumab to the date of any progression of disease as measured using bm RECIST with confirmation of response a minimum of 4 weeks later. b. Patients dying from causes other than melanoma or treatment related toxicity will be censored at the date of death. c. Patients alive without progression will be censored at the date of their last assessment. d. A diagnosis of a second primary melanoma is not considered a progression event., The incidence of non-neurological death in the whole patient population at 1 year from the start of nivolumab and ipilimumab where the immediate cause of death is due to melanoma but from causes other than brain metastases, a. Time from the start of nivolumab and ipilimumab to the date of death from any cause. b. Patients still alive at the end of the study will be censored at the date of their last assessment., a. The incidence of radionecrosis, diagnosed by imaging and / or histopathology assessment, occurring within 5 years from the start of the first course of radiotherapy in either treatment arm (i.e. the start of concurrent SRS with immunotherapy and / or the start of any form of salvage radiotherapy). b. The number of repeat radionecrosis events per patient., Incidence of salvage radiotherapy to intracranial brain metastases in each cohort, Incidence of craniotomy for intracranial brain metastases in each cohort, a. The mean change from baseline assessment [CTCAE neurocognitive adverse events, Montreal Cognitive Assessment [MoCA] and FACT-cog) to the time of best response and progression of disease. b. The duration of each neurocognitive deficit. c. Proportion of patients in each Cohort recording decreased neurocognitive function. d. The proportion of patients requiring an intervention to treat neurocognitive dysfunction., e. The correlation of neurocognitive function with neurological-specific death and overall survival. f. The correlation of patient-perceived cognitive impairment and researcher-rated neurocognitive function., a. The mean change from baseline quality of life scores [QLQ-C30, BN20, FACT-Br, EQ-5D-5L] to the time of response, stable disease or progression. b. Time from the start of nivolumab and ipilimumab to the time of deterioration of quality life scores and the duration of deterioration., The incidence of reduced functional performance by 1, 2 or 3 grades of the Eastern Cooperative Oncology Group (ECOG) performance status scale compared to baseline following at least ONE dose of nivolumab and ipilimumab, a. Number of adverse events by type, frequency, duration, relatedness to any treatment, relatedness to disease progression and severity of the event using National Cancer Institute Common Terminology Criteria for Adverse Events (CTCAE v5) b. Number of patients who discontinue any study treatment due to intolerable or serious adverse events. c. Number and nature of serious adverse events and events of clinical interest using CTCAE criteria., a. Correlation of the PD-L1 status, immune markers, genomics and other biomarkers of response and resistance in tumour tissue (extracranial and intracranial sites if possible, available and applicable) at baseline and at subsequent disease progression., b. Correlation of lymphocyte, T cell subsets, myeloid derived suppressor cells, genomic and other biomarkers in blood at baseline, at the commencement of radiotherapy (and conclusion of radiotherapy if fractionated), at complete or partial response and at subsequent disease progression. c. Investigation of histological features and biomarkers in brain tissue, if removed at biopsy or surgery., d. Investigation of the gut microbiome composition, diversity and abundance and correlation with baseline self-reported dietary habits, the response to immunotherapy and immune-related gastrointestinal toxicity. e. Correlation of gastrointestinal mucosal integrity with bacterial composition in stool samples, RECIST response and immune related adverse events.

Source: https://euclinicaltrials.eu/ctis-public/view/2024-518545-13-00